EU clinical trial 2024-516495-15-00: The efficacy, safety and neonatal effects of oxycodone in treatment of labour pain
Sponsor: Pohjois-Savon hyvinvointialue (Patient organisation/association). Phase: Therapeutic use (Phase IV). Countries: Finland (ongoing, recruiting).
Therapeutic area(s): Diseases [C] - Female Urogenital Diseases and Pregnancy Complications [C13]
Gender: Female. Age: 18-64 years. Enrolment: 12.
Status: Ongoing, recruiting. Start date (EU): 2024-08-12. Decision date: 2024-08-09. Results received: No. Last updated: 2024-08-09.

Condition(s): labour
Product: Oxanest® 10 mg/ml -injektioneste, liuos

Primary endpoint: Oxycodone concentration in mater and umbilical cord at time of birth
Endpoint(s): Population pharmacocinetic model of oxycodone in parturient

Source: https://euclinicaltrials.eu/ctis-public/view/2024-516495-15-00